EU clinical trial 2024-517739-35-00: Hyperbaric OXygen therapy for ACute Acoustic Trauma; HOXACAT
Sponsor: Amsterdam UMC Stichting (Patient organisation/association). Phase: Therapeutic confirmatory (Phase III). Countries: Netherlands (ended).
Therapeutic area(s): Diseases [C] - Otorhinolaryngologic Diseases [C09]
Gender: Female, Male. Age: 18-64 years, 65+ years. Enrolment: 84.
Status: Ended. End date (EU): 2025-12-31. Decision date: 2024-10-24. Results received: No. Last updated: 2025-09-15.

Condition(s): Acute acoustic trauma
Product: OXYGEN, OXYGEN

Primary endpoint: The absolute average hearing gain on all affected frequencies at one month of follow-up

Source: https://euclinicaltrials.eu/ctis-public/view/2024-517739-35-00